EU clinical trial 2024-515040-23-00: A phase 2, multi-center, open-label, randomized study of oral asciminib added to imatinib versus continued imatinib versus switch to nilotinib in patients with CML-CP who have been previously treated with imatinib and have not achieved deep molecular response
Protocol code: CABL001E2201
Sponsor: Novartis Pharma AG (Pharmaceutical company). Phase: Therapeutic exploratory (Phase II). Countries: France (ended), Spain (ended), Italy (ended), Czechia (ended), Austria (ended).
Therapeutic area(s): Diseases [C] - Neoplasms [C04]
Gender: Female, Male. Age: 18-64 years, 65+ years. Enrolment: 37.
Status: Ended. Start date (EU): 2018-11-26. End date (EU): 2025-02-26. End date: 2025-02-27. Decision date: 2024-09-20. Results received: Yes. Last updated: 2025-02-18.
Decision dates by country: AT: 2024-10-14, CZ: 2024-09-23, FR: 2024-09-20, ES: 2024-09-24, IT: 2024-09-24

Condition(s): Chronic Myelogenous Leukemia in chronic phase (CML-CP), previously treated with imatinib and have not achieved deep molecular response
Product: Scemblix 40 mg film-coated tablets, Scemblix 40 mg film-coated tablets, Scemblix 20 mg film-coated tablets, Scemblix 40 mg film-coated tablets, NILOTINIB, NILOTINIB, Scemblix 20 mg film-coated tablets, IMATINIB, IMATINIB

Primary endpoint: Molecular Response (MR)4.5 rate at 48 weeks
Endpoint(s): • Molecular Response (MR)4.5 rate at 48 weeks • Difference in rate of MR4.5 at 48 weeks, • Rate of MR4.5 at 96 weeks • Rate of MR4.5 by 48 and 96 weeks • Sustained MR4.5 at 96 weeks • Time to MR4.5, Incidence and severity of adverse events, changes in laboratory values, clinically notable ECG abnormalities and vital signs, Plasma concentrations of asciminib and imatinib when administered in combination. PK parameters include but are not limited to Cmax, Tmax, Cmin, AUClast and AUCtau

Source: https://euclinicaltrials.eu/ctis-public/view/2024-515040-23-00